EU clinical trial 2023-504944-32-00: A Phase 2, Single-arm, Open-label Clinical Trial of Pembrolizumab Plus Lenvatinib in Participants with First-line Advanced/Metastatic Non-clear Cell Renal Cell Carcinoma (nccRCC) (KEYNOTE-B61)
Protocol code: MK-3475-B61
Sponsor: Merck Sharp & Dohme LLC (Pharmaceutical company). Phase: Therapeutic exploratory (Phase II). Countries: Italy (ended), Spain (ended), Hungary (ended), Poland (ended), France (ended).
Therapeutic area(s): Diseases [C] - Neoplasms [C04]
Gender: Female, Male. Age: 18-64 years, 65+ years. Enrolment: 59.
Status: Ended. Start date (EU): 2021-02-17. End date (EU): 2025-10-20. End date: 2025-10-21. Decision date: 2023-08-09. Results received: No. Last updated: 2025-10-16.
Decision dates by country: ES: 2023-08-09, PL: 2023-08-14, IT: 2023-08-10, HU: 2023-08-10, FR: 2023-09-01

Condition(s): Non-clear Cell Renal Cell Carcinoma
Product: Lenvatinib, Lenvatinib, KEYTRUDA 25 mg/mL concentrate for solution for infusion

Primary endpoint: Objective Response Rate (ORR) is defined as the percentage of participants with a complete response (CR) or partial response (PR) per response evaluation criteria in solid tumors 1.1 (RECIST 1.1) by blinded independent central review (BICR).
Endpoint(s): Duration of Response (DOR) is defined for participants who demonstrate confirmed CR or PR as the time from first documented evidence of CR or PR until disease progression or death due to any cause, whichever occurs first., Progression-free Survival (PFS) is defined as the time from the date of first dose to the first documented progressive disease (PD) per RECIST 1.1 by BICR or death from any cause, whichever occurs first., Overall Survival (OS) is defined as the time from date of first dose until death from any cause., Clinical Benefit Ratio (CBR) is defined as the percentage of participants who achieved CR, PR, or stable disease (SD) for at least 6 months per RECIST 1.1 by BICR., Disease Control Rate (DCR) is defined as the percentage of participants who achieved CR, PR, or SD per RECIST 1.1 by BICR., Number of Participants Who Experienced One or More Adverse Events (AEs)., Number of Participants Who Discontinued Study Medication Due to an AE.

Source: https://euclinicaltrials.eu/ctis-public/view/2023-504944-32-00